EU clinical trial 2024-510849-34-00: A Phase 2, Randomized, Double-Blind, Multicenter, Placebo-Controlled Study with an Extension to Investigate the Efficacy and Safety of Solrikitug in Adults with Eosinophilic Esophagitis (ALAMERE)
Protocol code: NSI-8226-201
Sponsor: NI One Inc. (Pharmaceutical company). Phase: Therapeutic exploratory (Phase II). Countries: Belgium (ongoing, recruitment ended), Poland (ongoing, recruitment ended), Spain (ended), Italy (ongoing, recruitment ended), Netherlands (ended).
Therapeutic area(s): Diseases [C] - Immune System Diseases [C20]; Diseases [C] - Digestive System Diseases [C06]
Gender: Female, Male. Age: 18-64 years, 65+ years. Enrolment: 49.
Start date (EU): 2025-02-04. Decision date: 2024-12-02. Results received: No. Last updated: 2026-02-27.
Decision dates by country: BE: 2024-12-03, ES: 2024-12-02, IT: 2024-12-04, NL: 2024-12-09, PL: 2024-12-09

Condition(s): Eosinophilic Esophagitis
Product: solrikitug matching placebo, Solrikitug

Primary endpoint: 1_Part A: _Peak eosinophil count per HPF in biopsy specimens measured by the proportion of participants with <= 6 eos/HPF at Week 24 _Change in DSQ total score from baseline to Week 24, 2_Part B: _Incidence and severity of TEAEs _Safety data (e.g., clinical laboratory evaluations, vital signs, and 12-lead ECG results) _Injection site tolerability
Endpoint(s): 1_ Incidence and severity of TEAEs _Safety data (e.g., clinical laboratory evaluations, vital signs, and 12-lead ECG results) _Injection site tolerability, 2_PartA: _Peak eosinophil count per HPF in biopsy specimens as measured by the proportion of participants with <=15 eos/HPF at Week 24 _Percent change in peak eosinophil count from baseline to Week 24, 3_Various Patient Reported Outcomes and Quality of Life Measures for EoE at different timepoint during Part A and Part B), 4_PartA: __Summaries of concentration time data for each treatment/dose level _Summaries of ADA titers and ADA and NAb incidence, 6_PartB: _Peak eosinophil count per HPF in biopsy specimens measured by the proportion of participants with <= 6 eos/HPF and the change in DSQ total score from Week 24 to Week 52 _Percent change in peak eosinophil count from Week 24 to Week 52 _Peak eosinophil count per HPF in biopsy specimens measured by the proportion of participants with <= 15 eos/HPF from Week 24 to Week 52, 7_PartB: __Listings and summary of concentration time data _Summaries of ADA titers and ADA and NAb incidence

Source: https://euclinicaltrials.eu/ctis-public/view/2024-510849-34-00